EU clinical trial 2024-514962-38-00: Phase I/IIa, first-in-human, open-label, dose escalation trial with expansion cohorts to evaluate safety and preliminary efficacy of CLDN6 CAR-T with or without CLDN6 RNA-LPX in patients with CLDN6-positive relapsed or refractory advanced solid tumors
Protocol code: BNT211-01
Sponsor: BioNTech Cell & Gene Therapies GmbH (Pharmaceutical company). Phase: Human Pharmacology (Phase I)- First administration to humans. Countries: Sweden (ongoing, recruitment ended), Germany (ongoing, recruitment ended), Netherlands (ongoing, recruitment ended).
Therapeutic area(s): Diseases [C] - Neoplasms [C04]
Gender: Female, Male. Age: 18-64 years, 65+ years. Enrolment: 206.
Status: Ongoing, recruitment ended. Start date (EU): 2020-08-25. Decision date: 2024-07-01. Results received: No. Last updated: 2025-11-13.
Decision dates by country: NL: 2024-07-01, SE: 2024-07-03, DE: 2024-07-04

Condition(s): Solid Tumors
Product: BNT211, BNT211, BNT211, BNT211

Primary endpoint: Occurrence of treatment-emergent adverse events (TEAEs) including ≥ Grade 3, serious, fatal TEAEs by relationship, Occurrence of dose reduction and discontinuation of investigational medicinal product (IMP) due to TEAEs, Occurrence of dose-limiting toxicity (DLT) during the DLT evaluation period
Endpoint(s): Change from baseline in the levels and kinetics of soluble immune factors measured by cytokine multiplex assay, Objective response rate (ORR) defined as the proportion of patients in whom a complete response (CR) or partial response (PR) (per RECIST 1.1 or defined by tumor marker change from baseline when RECIST evaluation is not feasible) is observed as best overall response, Disease control rate (DCR) defined as the proportion of patients in whom a CR or PR or stable disease (SD) per RECIST 1.1 or defined by tumor marker change from baseline when RECIST evaluation is not feasible (SD assessed at least 6 weeks after the first dose) is observed as best overall response, Duration of response (DOR) defined as the time from first objective response (CR or PR per RECIST 1.1 or first response defined by tumor marker change from baseline when RECIST evaluation is not feasible) to first occurrence of objective PD or death from any cause, whichever occurs first

Source: https://euclinicaltrials.eu/ctis-public/view/2024-514962-38-00